EU clinical trial 2024-514344-82-00: EFRAIM II _ Empirical steroids and/or antifungals in immunocompromised patients with acute respiratory failure from undetermined etiology: a multicenter double-blind randomized controlled trial
Protocol code: APHP180584
Sponsor: Assistance Publique Hopitaux De Paris (Hospital/Clinic/Other health care facility). Phase: Therapeutic confirmatory (Phase III). Countries: France (ended).
Therapeutic area(s): Diseases [C] - Respiratory Tract Diseases [C08]
Gender: Female, Male. Age: 18-64 years, 65+ years. Enrolment: 420.
Status: Ended. Start date (EU): 2021-02-18. End date (EU): 2025-10-15. Decision date: 2024-07-19. Results received: No. Last updated: 2025-01-08.

Condition(s): patients with acute respiratory failure from undetermined etiology
Product: METHYLPREDNISOLONE, Placebo of CRESEMBA, CRESEMBA 200 mg powder for concentrate for solution for infusion, Placebo of methylprednisolone

Primary endpoint: Mortality at day 90
Endpoint(s): ICU mortality, hospital mortality, day 28 mortality, proportion of patients with ICU acquired microbiologically documented bacterial infections, proportion of patients with invasive fungal infection within 3 months following randomization, roportion of patients with HSV, VZV or CMV reactivation within 3 months following randomization, occurrence of severe hypokalemia (<2,5 meq/l), decompensated diabetes or severe or newly acquired hypertension, emergence of Aspergillus species with decreased sensitivity to isavuconazole, Incidence of Candida infection, incidence of post-traumatic Stress Disorder (IES-R), anxiety and depression at 6 months (HADS), quality of life at 6 months (SF36)

Source: https://euclinicaltrials.eu/ctis-public/view/2024-514344-82-00